EU clinical trial 2023-508727-12-00: A Phase 1/2 Multicenter, Open-label Study to Assess the Safety, Pharmacokinetics and Efficacy of CC-92480 Monotherapy and in Combination with Dexamethasone in Subjects with Relapsed and Refractory Multiple Myeloma
Protocol code: CC-92480-MM-001
Sponsor: Celgene Corp. (Pharmaceutical company). Phase: Therapeutic exploratory (Phase II). Countries: Belgium (ended), Spain (ended).
Therapeutic area(s): Diseases [C] - Neoplasms [C04]
Gender: Female, Male. Age: 18-64 years, 65+ years. Enrolment: 46.
Status: Ended. Start date (EU): 2018-04-12. End date (EU): 2025-09-02. End date: 2025-10-23. Decision date: 2024-02-06. Results received: No. Last updated: 2025-10-15.
Decision dates by country: BE: 2024-02-14, ES: 2024-05-14

Condition(s): Relapsed and refractory multiple myeloma (RRMM)
Product: CC-92480, Dexamethason acis 8 mg Tabletten, Dexamethason 8 mg JENAPHARM®, CC-92480, CC-92480, CC-92480, CC-92480, CC-92480, CC-92480, Dexamethason 4 mg JENAPHARM®, Dexamethason-ratiopharm® 4 mg Tabletten

Primary endpoint: Safety: Type, frequency, seriousness, severity and relationship of AEs to CC- 92480 and dexamethasone; changes from baseline in clinically-relevant physical findings, vital signs, selected laboratory analytes, ECGs and ECHO/MUGA scans., PK parameters: Area under the plasma concentration-time curve (AUC), maximal plasma concentration (Cmax), time to Cmax(Tmax), terminal-phase elimination half-life (t1/2),apparent total clearance of the drug from plasma after oral administration (CL/F) and apparent volume of distribution during terminal phase after non-intravenous administration (Vz/F) for CC- 92480 monotherapy and in combination with dexamethasone and the Renantiomer (CC0982796) of CC-92480 (if data allow)., Recommended Phase 2 Dose: Establish the MTD/RP2D for CC-92480 monotherapy and in combination with dexamethasone at each dosing schedule., Overall Response Rate (ORR) Best response ≥ partial response (PR), according to the IMWG Uniform Response Criteria.
Endpoint(s): Overall response rate (ORR): Best response ≥ PR, according to the IMWG Uniform Response Criteria., Safety: Type, frequency, seriousness, severity and relationship of AEs to CC- 92480 and dexamethasone; changes from baseline in clinically-relevant physical findings, vital signs, selected laboratory analytes, ECGs and ECHO/MUGA scans., Time to response (TTR): Time from 1st dose of CC-92480 to the first documentation of response ≥ PR., Duration of response (DOR): Time from the first documentation of response ( ≥ PR) to the first documentation of PD or death., Progression free survival: Time from 1st dose of CC-92480 to the first occurrence of disease progression or death from any cause., Overall survival (OS): Time from first dose of CC-92480 to death due to any cause

Source: https://euclinicaltrials.eu/ctis-public/view/2023-508727-12-00